EU clinical trial 2025-521380-12-00: PainCart Study Evaluating the Analgesic Profile of SAGE-319
Protocol code: 319-TRM-101
Sponsor: Sage Therapeutics Inc. (Pharmaceutical company). Phase: Human Pharmacology (Phase I)- Other. Countries: Netherlands (ended).
Therapeutic area(s): Psychiatry and Psychology [F] - Mental Disorders [F03]
Gender: Female, Male. Age: 18-64 years. Enrolment: 24.
Status: Ended. Start date (EU): 2025-06-02. End date (EU): 2025-06-17. Decision date: 2025-05-30. Results received: No. Last updated: 2025-05-30.

Condition(s): Disorders characterized by a deficit in GABAergic signaling and cerebellar circuitry.

Source: https://euclinicaltrials.eu/ctis-public/view/2025-521380-12-00